EU clinical trial 2024-515315-22-00: S-ketamine for cortical spreading depolarisation in patients with severe acute brain injury (KETA-BID trial)
Protocol code: RHNIA-001-2021
Sponsor: Rigshospitalet (Hospital/Clinic/Other health care facility). Phase: Therapeutic use (Phase IV). Countries: Denmark (ongoing, recruiting).
Therapeutic area(s): Diseases [C] - Pathological Conditions, Signs and Symptoms [C23]; Diseases [C] - Nervous System Diseases [C10]
Gender: Female, Male. Age: 18-64 years, 65+ years. Enrolment: 400.
Status: Ongoing, recruiting. Start date (EU): 2023-09-15. Decision date: 2024-09-12. Results received: No. Last updated: 2026-07-20.

Condition(s): subarachnoid hemorrhage, intracerebral hemorrhage, traumatic brain injury
Product: ESKETAMINE HYDROCHLORIDE, SODIUM CHLORIDE

Primary endpoint: Occurrence of cortical spreading depolarisations per hour of monitoring after randomisation
Endpoint(s): Rate of adverse events and adverse reactions after randomisation and throughout the intervention period, Functional outcome (using modified Rankin Scale and Glasgow Outcome Scale-Extended) at 6 months after randomisation

Source: https://euclinicaltrials.eu/ctis-public/view/2024-515315-22-00